EU clinical trial 2024-518519-20-01: Phase II, multicenter, double-blind, randomized, placebo-controlled, parallel-group, multicenter clinical trial to evaluate the safety and clinical efficacy of subcutaneous immunotherapy with purified Der p 1/Der p 2/Der p 23 allergens at different doses in patients with moderate/severe allergic rhinitis/rhinoconjunctivitis with/without controlled allergic asthma due to sensitization to Dermatophagoides spp.
Protocol code: DIA-EC-MOLMite-01-24
Sponsor: Diater Laboratorio De Diagnostico Y Aplicaciones Terapeuticas S.A. (Pharmaceutical company). Phase: Therapeutic exploratory (Phase II). Countries: Spain (ongoing, recruitment ended).
Therapeutic area(s): Diseases [C] - Immune System Diseases [C20]
Gender: Female, Male. Age: 18-64 years, 65+ years. Enrolment: 160.
Status: Ongoing, recruitment ended. Start date (EU): 2025-04-10. Decision date: 2025-03-28. Results received: No. Last updated: 2025-09-01.

Condition(s): moderate/severe allergic rhinitis/rhinoconjunctivitis with/without controlled allergic asthma due to sensitization to Dermatophagoides genus
Product: Hidróxido de Aluminio 0,08 mg/ml; Solución inyectable salina (0,9%) C.S.P: 1 ml and Histamina 0,01 μg/ml, MOLMite

Primary endpoint: Comparison of the required protein dose of Der p 1/ Der p 2/ Der p 23 extract, to trigger a positive CPP, performed at baseline, and after 12 maintenance doses comparing placebo with the 3 active treatment arms (Der p 1/Der p 2/Der p 23) at different doses.
Endpoint(s): Change in combined symptom and medication score (CSMS1) from baseline and after 6 and 12 maintenance doses., Change in symptom score (dSS) from baseline and after 6 and 12 maintenance doses., Change in medication score (dMS) from baseline and after 6 and 12 maintenance doses., Change in patient-reported visual analog scale (VAS) score on rhinoconjunctivitis and asthma symptoms (if applicable) (Appendix 7), from baseline and after 6 and 12 maintenance doses., Change in severity of rhinitis and rhinoconjunctivitis as classified by the ARIA2 guideline (Appendix 8) from baseline and after 6 and 12 maintenance doses, Change in quality of life, according to the mini-RQLQ (Rhinoconjunctivitis Quality of Life Questionnaire3, Appendix 9), from baseline and after 6 and 12 maintenance doses, Change in lung function, according to forced expiratory volume in the first second (FEV1), from baseline and after 6 and 12 maintenance doses., Percentage of patients showing improvement in CPP after 12 maintenance doses. To be considered an improvement, the concentration required to obtain a positive test after 12 doses must be higher (at least one dilution less) than that required at the baseline visit., Degree of asthma control, according to the ACT questionnaire (Asthma Control Test4, Appendix 10), at baseline and after 6 and 12 maintenance doses., Change in asthma severity, according to GINA guideline 20245 (Appendix 11), from baseline, after 6 and 12 maintenance doses., Number of exacerbations defined as i. any worsening of asthma requiring hospitalizations or emergency department visits and necessitating systemic corticosteroid treatment for ≥ 3 consecutive days, or ii. any exacerbation requiring initiation or increase in baseline systemic corticosteroid intake for ≥ 3 consecutive days at baseline, after 6 and 12 maintenance doses. from baseline and after 6 and 12 maintenance doses., Oral corticosteroid (CEO) consumption at baseline (during the previous year) and after 6 and 12 doses (since the previous visit). Measured as the number of cycles of at least 3 days of CEO., IgE levels (total and specific: D. pteronyssinus, Der p 1, Der p 2, and Der p 23) at basal, after 6 doses and after 12 maintenance doses., IgG4 levels (total and specific: D. pteronyssinus, Der p 1, Der p 2, and Der p 23) at baseline, after 6 doses and after 12 maintenance doses., IgE/IgG4 ratio, at baseline, after 6 doses and after 12 maintenance doses., Skin sensitization by prick test (intraepidermal skin test). Change in papule size after administration of D. pteronyssinus extract and Der p 1, Der p 2, and Der p 23 extracts at basal, after 6 doses and after 12 maintenance doses., Severity/grade of systemic and local adverse reactions according to the 2010 World Allergy Organization (WAO, 2010) criteria6 (Appendix 12 and Appendix 13)., Percentage (%) of adverse reactions (ARs) per 100 administrations (injections)., Percentage (%) of patients with at least one AR per 100 administrations (injections), Description of therapeutic measures for the management of ARs as well as their outcome.

Source: https://euclinicaltrials.eu/ctis-public/view/2024-518519-20-01